EU clinical trial 2023-508559-37-00: A randomized, double-blind, parallel group, placebo-controlled, multicenter phase 3 trial to evaluate the efficacy, safety and tolerability of ianalumab on top of standard-of-care therapy in participants with active lupus nephritis (SIRIUS-LN)
Protocol code: CVAY736K12301
Sponsor: Novartis Pharma AG (Pharmaceutical company). Phase: Therapeutic confirmatory (Phase III). Countries: Hungary (ongoing, recruitment ended), Estonia (ongoing, recruitment ended), Lithuania (ongoing, recruitment ended), Spain (ongoing, recruitment ended), Romania (ongoing, recruitment ended), Italy (ongoing, recruitment ended), Germany (ongoing, recruitment ended), Czechia (ongoing, recruitment ended), France (ongoing, recruitment ended).
Therapeutic area(s): Diseases [C] - Immune System Diseases [C20]
Gender: Female, Male. Age: 18-64 years, 65+ years. Enrolment: 57.
Status: Ongoing, recruitment ended. Start date (EU): 2022-07-14. Decision date: 2024-07-19. Results received: No. Last updated: 2026-05-25.
Decision dates by country: ES: 2024-07-22, EE: 2024-07-23, HU: 2024-07-19, DE: 2024-07-23, FR: 2024-07-23, RO: 2024-07-23, CZ: 2024-07-24, LT: 2024-07-24, IT: 2024-07-24

Condition(s): Lupus nephritis
Product: MYCOPHENOLATE MOFETIL, VAY736, ENTECAVIR, Placebo to VAY736 150 mg/1 mL Solution for injection in pre-filled syringe , Placebo to VAY736 300 mg/2 mL Solution for injection in pre-filled syringe, MYCOPHENOLIC ACID, VAY736, TENOFOVIR ALAFENAMIDE, TENOFOVIR DISOPROXIL

Primary endpoint: Achieving stable CRR at Week 72; participants who discontinue treatment before Week 72 or use corticosteroids at a dose >7.5 mg/day after Week 60 will be considered non-responders
Endpoint(s): Time to first occurrence of XX from baseline up to Week 72, Achieving stable CRR at Week 72 while maintaining daily corticosteroid dose ≤5mg/day between Week 24 and Week 72. Participants who discontinue treatment before Week 72 will be considered non-responders, Experiencing renal flares related event or death through Week 72, Achieving of stable ORR at Week 48; participants who discontinue treatment before Week 48 or use corticosteroids at a dose >7.5 mg/day after Week 36 will be considered non-responders, Change from baseline in BILAG-2004 at Week 72, Change from baseline in FACIT-Fatigue at Week 72, Treatment-emergent Adverse Events (TEAEs), Serious Adverse Events (SAEs), Vital signs, Clinical laboratory measurements, Ianalumab concentration in serum and calculated PK parameters, Incidence and titer of anti-ianalumab antibodies in serum (ADA assay) over time

Source: https://euclinicaltrials.eu/ctis-public/view/2023-508559-37-00